EU clinical trial 2024-511290-30-00: A Phase IIb, Open-label, Randomized Study of Nab-Paclitaxel and Gemcitabine plus/minus VCN-01 in Patients with Metastatic Pancreatic Cancer (VIRAGE)
Protocol code: P-VCNA-003
Sponsor: Theriva Biologics S.L. (Pharmaceutical company). Phase: Therapeutic exploratory (Phase II). Countries: Spain (ended).
Therapeutic area(s): Diseases [C] - Neoplasms [C04]
Gender: Female, Male. Age: 18-64 years, 65+ years. Enrolment: 92.
Status: Ended. Start date (EU): 2022-11-15. End date (EU): 2025-03-28. End date: 2025-03-29. Decision date: 2024-10-02. Results received: Yes. Last updated: 2024-11-21.

Condition(s): Metastatic Pancreatic Cancer
Product: VCN-01

Primary endpoint: OS, Safety and tolerability
Endpoint(s): PFS or TTP, ORR, DCR (SD + PR + CR), Landmark 1-year survival and PFS at the 1-year landmark, DoR, Changes in tumor marker Ca 19.9

Source: https://euclinicaltrials.eu/ctis-public/view/2024-511290-30-00